EU clinical trial 2024-515636-77-00: An exploratory study of [18F]AlF-NOTA-octreotide high resolution NeuroEXPLORER PET and MRI in carotid artery disease
Protocol code: S68914
Sponsor: UZ Leuven (Hospital/Clinic/Other health care facility). Phase: Therapeutic exploratory (Phase II). Countries: Belgium (ongoing, recruiting).
Therapeutic area(s): Diseases [C] - Cardiovascular Diseases [C14]
Gender: Female, Male. Age: 18-64 years, 65+ years. Enrolment: 24.
Status: Ongoing, recruiting. Start date (EU): 2025-03-16. Decision date: 2024-11-18. Results received: No. Last updated: 2026-03-18.

Condition(s): Carotid artery atherosclerosis
Product: [18F]AlF-NOTA-Octreotide

Primary endpoint: The quantification of [18F]AlF-OC uptake in the culprit and non-culprit carotid artery by measures of standardized uptake value (SUV)
Endpoint(s): The predictive value of baseline plaque SUV for the recurrence of ipsilateral TIA, amaurosis fugax and stroke during 3 years follow-up, the recurrence of all stroke/TIA, the occurrence of any vascular complication (stroke/TIA, myocardial infarction, cardiac arrest, hospitalisation for unstable angina or vascular death) and the occurrence of all-cause mortality

Source: https://euclinicaltrials.eu/ctis-public/view/2024-515636-77-00